EU clinical trial 2023-503536-40-00: (15681) Open-label, individual dose titration study to evaluate safety, tolerability and pharmacokinetics of riociguat in children from 6 to less than 18 years of age with pulmonary arterial hypertension (PAH)
Protocol code: BAY63-2521/15681
Sponsor: Bayer AG (Pharmaceutical company). Phase: Therapeutic confirmatory (Phase III). Countries: Italy (ongoing, recruitment ended), Germany (ongoing, recruitment ended).
Therapeutic area(s): Diseases [C] - Cardiovascular Diseases [C14]
Gender: Female, Male. Age: 0-17 years. Enrolment: 12.
Status: Ongoing, recruitment ended. Start date (EU): 2016-02-23. Decision date: 2023-08-14. Results received: No. Last updated: 2026-02-25.
Decision dates by country: DE: 2023-08-24, IT: 2023-08-14

Condition(s): Pulmonary arterial hypertension (PAH)
Product: Riociguat Bayer, Riociguat Bayer Granules for oral suspension, Riociguat Bayer, Riociguat Bayer, Riociguat Bayer, Riociguat Bayer

Primary endpoint: Incidence of adverse events and serious adverse events, Recording of vital signs, Left-hand x-ray, Pharmacokinetics/Pharmacodynamics analyses
Endpoint(s): 6-Minute Walking Distance (6MWD)., WHO functional class., N-terminal prohormone brain-type natriuretic peptide., Quality of Life scores (parent questionnaire and in children able to understand questions): Child Health-related Questionnaire (SF-10) and PedsQL Generic Core scales self-report, Echocardiographic parameters including: o pulmonary arterial systolic pressure (PASP), o tricuspid annular plane systolic excursion (TAPSE), o pericardial effusion, o left ventricular eccentricity index, o estimated right atrial pressure o right ventricular pressure by tricuspide regurgitant jet velocity, o acceleration time of pulmonary flow o right heart dimensions and o computing of cardiac output, Time to clinical worsening defined as: o hospitalization for right heart failure, o death, o lung transplantation, o Pott’s anastomosis and atrioseptostomy o worsening of PAH symptoms, which must include either an increase in WHO functional class, OR both appearance/worsening symptoms of right heart failure AND need for additional PAH therapy., Taste and texture of the pediatric formulation(s) must be assessed by use of a questionnaire.

Source: https://euclinicaltrials.eu/ctis-public/view/2023-503536-40-00